EU clinical trial 2023-509042-35-01: Randomized Phase 2 study testing two conditioning regimen with a single prophylaxis of graft-versus-host disease by cyclophosphamide and methotrexate post-transplant in patients eligible for matched-donor allograft transplantation _ CY-MET-RIC
Protocol code: RC23_0286
Sponsor: Centre Hospitalier Universitaire De Nantes (Hospital/Clinic/Other health care facility). Phase: Therapeutic exploratory (Phase II). Countries: France (ongoing, recruiting).
Therapeutic area(s): Diseases [C] - Immune System Diseases [C20]; Diseases [C] - Hemic and Lymphatic Diseases [C15]
Gender: Female, Male. Age: 18-64 years, 65+ years. Enrolment: 82.
Status: Ongoing, recruiting. Start date (EU): 2024-07-18. Decision date: 2024-04-08. Results received: No. Last updated: 2025-06-19.

Condition(s): Adults patients will be included in the hematology departments. Eligible patients will be those scheduled to receive an allo-HSC after a RIC conditioning regimen for a myeloid or lymphoid hematological malignancy with a family or non-family HLA-matched donor 10/10
Product: METHOTREXATE, FLUDARABINE, THIOTEPA, CYCLOPHOSPHAMIDE, BUSULFAN, ANTI-HUMAN T-LYMPHOCYTE IMMUNOGLOBULIN FROM RABBITS, CLOFARABINE, CYCLOPHOSPHAMIDE

Primary endpoint: The incidence of corticoresistant grade 3 and 4 acute GVH following allo-HSC according to Mount Sinai criteria. Corticoresistance is assessed according to the criteria of Mohty et al and defined as either -> after 5 to 7 days of 2 mg/kg systemic corticosteroids: worsening or non-improvement of GVH -> after 14 days of 2 mg/kg systemic corticosteroids: absence of complete remission of GVHD. Corticoresistant acute GVH following DLI injection will be excluded
Endpoint(s): Graft uptake assessed on hematological reconstitution (number of days of aplasia with PNN <0.5 G/L and platelets < 20, number of platelet and red cell concentrate transfusions), OS at 1 year and last follow-up (survival between day 0 of transplantation and date of death or last follow-up), DFS at 1 year and last follow-up (survival from day 0 of transplantation to date of relapse, death or last follow-up), GRFS at 1 year and last follow-up (relapse-free survival without grade 3-4 acute GVH or chronic GVH requiring systemic treatment), Acute GVHD grade 2-4 according to Mount Sinai criteria, Chronic GVHD according to NCI criteria, NRM: any death unrelated to relapse or disease progression at 1 year and last follow-up, Relapse: any documented disease recurrence at 1 year and last follow-up, Total donor or mixed chemism at M1, M2, M3, M6, M12. Total donor chimerism = result >95% donor CD3+ and CD34+ cells. Mixed chimerism = result > 5% and < 95% donor CD3+ cells (routine test), Immune reconstitution at M3, M6, M9, M12: lymphocyte, monocyte, T4, T8, NK and B cell counts (routine examination), Grade 3 and 4 post-transplant adverse events (dates of occurrence) (NCI CTCAE version 5 criteria), Infections: viral (CMV, EBV, BKV, adenovirus), bacteriological, fungal and parasitic

Source: https://euclinicaltrials.eu/ctis-public/view/2023-509042-35-01